EU clinical trial 2023-506937-30-00: RANDOMISED, CROSSOVER BIOEQUIVALENCE CLINICAL TRIAL OF MONTELUKAST 10 MG CAPSULES VS MONTELUKAST 10 MG FILM-COATED TABLETS, AFTER A SINGLE ORAL DOSE ADMINISTRATION TO HEALTHY VOLUNTEERS UNDER FASTING CONDITIONS.
Protocol code: UECHUP-MON/23-4
Sponsor: Laboratorios Alter S.A. (Pharmaceutical company). Phase: Human Pharmacology (Phase I)- Bioequivalence Study. Countries: Spain (ended).
Therapeutic area(s): Diseases [C] - Respiratory Tract Diseases [C08]
Gender: Female, Male. Age: 18-64 years. Enrolment: 36.
Status: Ended. Start date (EU): 2023-09-20. End date (EU): 2023-10-16. Decision date: 2023-09-04. Results received: Yes. Last updated: 2023-09-04.

Condition(s): Asthma
Product: Montelukast 10 mg capsulas, Singulair 10 mg comprimidos recubiertos con película

Primary endpoint: AUC0-t and Cmax of montelukast
Endpoint(s): AUC0-∞, Tmax and residual area of montelukast.

Source: https://euclinicaltrials.eu/ctis-public/view/2023-506937-30-00